EU clinical trial 2024-516908-42-00: A phase II multicenter study of carfilzomib, lenalidomide and dexamethasone (KRd) as induction therapy, followed by high-dose therapy with melphalan and autologous peripheral blood stem cell transplantation, consolidation with KRd, and maintenance with lenalidomide and dexamethasone in patients ≤ 70 years old with smoldering multiple myeloma (SMM) with high risk of progression to symptomatic myeloma
Sponsor: Fundacion PETHEMA (Patient organisation/association). Phase: Therapeutic exploratory (Phase II). Countries: Spain (ongoing, recruitment ended).
Therapeutic area(s): Diseases [C] - Neoplasms [C04]
Gender: Female, Male. Age: 18-64 years, 65+ years. Enrolment: 90.
Status: Ongoing, recruitment ended. Start date (EU): 2015-06-15. Decision date: 2024-10-23. Results received: No. Last updated: 2025-10-27.

Condition(s): Smoldering multiple myeloma with high risk of progression to symptomatic myeloma
Product: DEXAMETHASONE, Imnovid 2 mg hard capsules, Imnovid 1 mg hard capsules, DARATUMUMAB, Imnovid 3 mg hard capsules, Imnovid 4 mg hard capsules

Primary endpoint: • Immunophenotypic complete remission (CR by flow cytometry) day +100 after induction treatment and HDT-ASCT.
Endpoint(s): • Immunophenotypic complete remission (CR by flow cytometry), after consolidation and maintenance, and at 3 and 5 years post-HDT-ASCT., • Response rates (sCR, CR, VGPR and ORR) after the different phases of treatment (induction, HDT-ASCT, consolidation, maintenance and rescue therapy)., • TTP to symptomatic disease, PFS and OS., • Safety profile after the different phases of treatment: induction, high-dose melphalan treatment and autologous hematopoietic stem cell transplantation, consolidation, maintenance and rescue therapy.

Source: https://euclinicaltrials.eu/ctis-public/view/2024-516908-42-00